EU clinical trial 2023-503219-14-01: A Phase 2/3, randomized, double-blind, placebo-controlled, parallel-group study to evaluate the efficacy and safety of belimumab administered subcutaneously in adults with systemic sclerosis associated interstitial lung disease (SSc-ILD)
Protocol code: 218224
Sponsor: Glaxosmithkline Research & Development Limited (Pharmaceutical company). Phase: Phase II and Phase III (Integrated). Countries: Germany (ongoing, recruiting), Greece (ongoing, recruiting), France (ongoing, recruiting), Finland (ended), Denmark (ended), Spain (ongoing, recruiting), Italy (ongoing, recruiting), Belgium (ongoing, recruiting).
Therapeutic area(s): Diseases [C] - Skin and Connective Tissue Diseases [C17]
Gender: Female, Male. Age: 18-64 years, 65+ years. Enrolment: 123.
Start date (EU): 2024-05-22. Decision date: 2024-03-04. Results received: No. Last updated: 2026-06-26.
Decision dates by country: GR: 2024-03-07, DK: 2024-03-04, FI: 2024-03-04, BE: 2024-03-05, ES: 2024-03-04, DE: 2024-03-07, FR: 2024-03-04, IT: 2024-03-11

Condition(s): systemic sclerosis associated interstitial lung disease
Product: Benlysta 200 mg solution for injection in pre-filled syringe., Placebo for Belimumab Solution for Injection, 200 mg/mL

Primary endpoint: Absolute change from baseline in FVC (mL) at Week 52.
Endpoint(s): 1. Absolute change from baseline in mRSS at Week 52. 2. Absolute change from baseline in FACIT-Fatigue score at Week 52. 3. Time to SSc progression or death.

Source: https://euclinicaltrials.eu/ctis-public/view/2023-503219-14-01